EU clinical trial 2024-515125-28-00: A Global Phase 2b, Randomized, Double-Blinded, Placebo-Controlled Trial to Evaluate the Efficacy and Safety of Ninerafaxstat in Patients with Symptomatic Non Obstructive Hypertrophic Cardiomyopathy – FORTITUDE-HCM
Protocol code: IMB101-010
Sponsor: Imbria Pharmaceuticals Inc. (Pharmaceutical company). Phase: Therapeutic exploratory (Phase II). Countries: Austria (ongoing, recruiting), Germany (ongoing, recruiting), Belgium (ongoing, recruiting), France (ongoing, recruiting), Portugal (ongoing, recruiting), Spain (ongoing, recruiting), Netherlands (ongoing, recruiting), Italy (ongoing, recruiting), Poland (ongoing, recruiting).
Therapeutic area(s): Diseases [C] - Cardiovascular Diseases [C14]
Gender: Female, Male. Age: 18-64 years, 65+ years. Enrolment: 130.
Status: Ongoing, recruiting. Start date (EU): 2025-12-08. Decision date: 2025-11-20. Results received: No. Last updated: 2026-06-17.
Decision dates by country: BE: 2025-11-20, FR: 2025-11-21, AT: 2025-11-23, PT: 2025-11-21, PL: 2025-11-30, NL: 2025-11-20, ES: 2025-11-21, DE: 2025-11-20, IT: 2025-11-20

Condition(s): Non-obstructive hypertrophic cardiomyopathy
Product: Ninerafaxstat, Tablet, identical in appearance to ninerafaxstat tablets

Primary endpoint: Change from baseline to Week 12 in Kansas City Cardiomyopathy Questionnaire Clinical Summary Score (KCCQ-CSS).
Endpoint(s): 1. Change in ventilatory efficiency (VE/VCO2 slope) during CPET from baseline to Week 12, 2. Change from baseline to Week 12 in the KCCQ-TSS, 3. Change from baseline to Week 12 in the KCCQ-PLS, 4. Change from baseline to Week 12 in the KCCQ-OSS, 5. Change in exercise duration during CPET from baseline to Week 12

Source: https://euclinicaltrials.eu/ctis-public/view/2024-515125-28-00